EU clinical trial 2024-519611-33-00: Contrast enhanced ultrasound and elastography of the neonatal brain
Protocol code: TL16102021
Sponsor: Varsinais-Suomen hyvinvointialue (Hospital/Clinic/Other health care facility). Phase: Therapeutic use (Phase IV). Countries: Finland (authorised, recruitment pending).
Therapeutic area(s): Diseases [C] - Congenital, Hereditary, and Neonatal Diseases and Abnormalities [C16]; Analytical, Diagnostic and Therapeutic Techniques and Equipment [E] - Diagnosis [E01]
Gender: Female, Male. Age: 0-17 years. Enrolment: 200.
Status: Authorised, recruitment pending. Decision date: 2024-12-10. Results received: No. Last updated: 2024-12-10.

Condition(s): Vastasyntyneiden hypoksis-iskeeminen aivovaurio, vastasyntyneiden aivohalvaus, vastasyntyneiden keskushermostoinfektiot, entiset keskoset lasketussa ajassa
Product: SonoVue 8 microlitres/mL powder and solvent for dispersion for injection

Primary endpoint: Kun saadaan kerättyä: a. 20-30 täysiaikaisena syntynyttä lasta, jotka ensimmäisen elinpäivän aikana vähintään hetkellisesti hoidossa vastasyntyneiden teho-osastolla. b. 20-30 asfyksiasta ja/tai hypoksis-iskeemisestä aivovauriosta kärsivää lasta c. 10-20 aivoinfarktista kärsivää lasta d. 80-100 ennenaikaisesti syntynyttä lasta e. 10-20 muusta aivopatologiasta kärsivää lasta

Source: https://euclinicaltrials.eu/ctis-public/view/2024-519611-33-00